EU clinical trial 2025-524052-58-00: Multiple Dose Study of RO7795068 and its effect on Gastric Emptying, and on PK of Oral Contraceptives
Protocol code: BP45910
Sponsor: F. Hoffmann-La Roche AG (Pharmaceutical company). Phase: Human Pharmacology (Phase I)- Other. Countries: Netherlands (ongoing, recruiting).
Therapeutic area(s): Diseases [C] - Nutritional and Metabolic Diseases [C18]
Gender: Female, Male. Age: 18-64 years, 65+ years. Enrolment: 60.
Status: Ongoing, recruiting. Start date (EU): 2026-05-21. Decision date: 2026-05-15. Results received: No. Last updated: 2026-05-15.

Condition(s): Healthy Overweight or Obese

Source: https://euclinicaltrials.eu/ctis-public/view/2025-524052-58-00